EU clinical trial 2022-502168-19-00: INCA34176-254: A Phase 2, Open-Label, Randomized, Multicenter Study to Evaluate the Safety and Efficacy of Axatilimab in Combination With Ruxolitinib in Participants With Newly Diagnosed Chronic Graft-Versus-Host Disease
Protocol code: INCA34176-254
Sponsor: Incyte Corp. (Pharmaceutical company). Phase: Therapeutic exploratory (Phase II). Countries: Germany (ongoing, recruitment ended), Belgium (ongoing, recruitment ended), Spain (ongoing, recruitment ended), Italy (ongoing, recruitment ended).
Therapeutic area(s): Diseases [C] - Immune System Diseases [C20]
Gender: Female, Male. Age: 0-17 years, 18-64 years, 65+ years. Enrolment: 70.
Status: Ongoing, recruitment ended. Start date (EU): 2024-10-22. Decision date: 2024-09-09. Results received: No. Last updated: 2026-07-14.
Decision dates by country: ES: 2024-09-09, BE: 2024-09-10, IT: 2024-09-10, DE: 2024-09-10

Condition(s): chronic graft-versus-host disease
Product: PREDNISONE, METHYLPREDNISOLONE, Axatilimab (INCA034176), Jakavi 5 mg tablets

Primary endpoint: Overall response (OR) at 6 months, defined for each treatment group as CR or PR at 6 months in the absence of new systemic therapy for cGVHD. Response assessment will be based on the 2014 NIH Criteria
Endpoint(s): Safety and tolerability will be assessed by evaluating the frequency and severity of AEs (including SAEs) and changes in clinical and laboratory assessments., DOR (in responders only), Proportion of participants with ≥ 7-point improvement in mLSS total score., Best overall response in the first 6 months and on study, based on the 2014 NIH Consensus Criteria, OR at 12 months, defined as CR or PR at 12 months, PK parameters for axatilimab and ruxolitinib, • EFS, defined as the time from the date of randomization to the date of addition or initiation of new systemic therapy for cGVHD, death due to any cause, or Day 1 in the case of treatment failure (ie, non-CR or non-PR by Month 6), whichever occurs first.

Source: https://euclinicaltrials.eu/ctis-public/view/2022-502168-19-00